EU clinical trial 2023-505476-29-00: A Multicenter, Randomized, Double-Blind, Placebo-Controlled Study to Evaluate the Safety and Efficacy of Upadacitinib in Subjects with Giant Cell Arteritis
Protocol code: M16-852
Sponsor: AbbVie Deutschland GmbH & Co. KG (Pharmaceutical company). Phase: Therapeutic confirmatory (Phase III). Countries: Denmark (ended), Belgium (ended), Germany (ended), Greece (ended), Sweden (ended), Spain (ended), Portugal (ended), France (ended), Netherlands (ended), Hungary (ended).
Therapeutic area(s): Diseases [C] - Immune System Diseases [C20]
Gender: Female, Male. Age: 18-64 years, 65+ years. Enrolment: 201.
Status: Ended. Start date (EU): 2019-04-05. End date (EU): 2025-02-24. End date: 2025-03-11. Decision date: 2024-07-23. Results received: Yes. Last updated: 2024-10-28.
Decision dates by country: BE: 2024-07-29, DK: 2024-07-24, FR: 2024-07-25, DE: 2024-07-26, GR: 2024-08-22, HU: 2024-07-25, PT: 2024-07-30, SE: 2024-07-24, NL: 2024-07-24, ES: 2024-07-23

Condition(s): Giant Cell Arteritis
Product: Prednisolon 1 mg JENAPHARM, Prednisolon 5 mg JENAPHARM, Prednisolone placebo-5mg, Prednisolon 20 mg JENAPHARM, Prednisolone placebo-10mg, Prednisolon 10 mg JENAPHARM, Upadacitinib placebo, Upadacitinib, Prednisolone placebo-20mg, Prednisolone placebo-1mg, Upadacitinib

Primary endpoint: The proportion of subjects achieving sustained remission at Week 52 as defined as: • Absence of GCA signs and symptoms from Week 12 through Week 52 • Adherence to the protocol defined corticosteroid taper regimen
Endpoint(s): 1. Proportion of subjects achieving sustained complete remission from Week 12 through Week 52, 2. Cumulative CS exposure, 3. Time to first disease flare. Disease flare is defined as an event determined by the investigator to represent recurrence of GCA signs or symptoms or an ESR measurement > 30 mm/hr attributable to GCA, AND requiring an increase in CS dose., 4. Proportion of subjects who experience at least 1 disease flare through Week 52., 5. Proportion of subjects in complete remission at Week 52. Complete remission is defined as having achieved all of the following: - Absence of GCA signs and symptoms; - Normalization of ESR to < 30 mm/hr; - Normalization of hsCRP to < 1 mg/dL; and - Adherence to the protocol-defined CS taper regimen., 6. Proportion of subjects in complete remission at Week 24., 7. Change from Baseline in the 36-item Short Form Quality of Life Questionnaire (SF-36) Physical Component Score (PCS) at Week 52., 8. Number of disease flares per subject during Period 1. • Change from Baseline in Functional Assessment of Chronic Illness Therapy-Fatigue (FACIT-F) at Week 52. • Assessment of Treatment Satisfaction Questionnaire for Medication (TSQM) patient global satisfaction subscale at Week 52. • Rate of CS-related AEs.

Source: https://euclinicaltrials.eu/ctis-public/view/2023-505476-29-00